EU clinical trial 2024-516184-87-00: An open label, randomized, two-period, two-sequence, crossover bioavailability study to assess the pharmacokinetic and safety profile of Valacyclovir Oral Suspension compared to European sourced Valtrex® Tablets in normal, healthy subjects under fasting conditions.
Protocol code: HY-029-04
Sponsor: Dermax (Pharmaceutical company). Phase: Human Pharmacology (Phase I)- Bioequivalence Study. Countries: Czechia (ended).
Therapeutic area(s): Diseases [C] - Skin and Connective Tissue Diseases [C17]; Diseases [C] - Virus Diseases [C02]
Gender: Female, Male. Age: 18-64 years. Enrolment: 30.
Status: Ended. Start date (EU): 2024-10-18. End date (EU): 2024-11-03. Decision date: 2024-09-13. Results received: No. Last updated: 2024-09-13.

Condition(s): not applicable (submitted trial is a bioavailability study in healthy subjects)

Source: https://euclinicaltrials.eu/ctis-public/view/2024-516184-87-00